EU clinical trial 2024-519541-30-00: Can high-flow oxygen enhance oxygenation during exercise by optimizing the benefits of Pulmonary Rehabilitation in patients with Diffuse Interstitial Lung Disease (ILD) with oxygen desaturation during effort?
Protocol code: IIBSP-OXI-2017-18
Sponsor: Fundacio Institut De Recerca De L'Hospital De La Santa Creu I Sant Pau (Hospital/Clinic/Other health care facility). Phase: Therapeutic confirmatory (Phase III). Countries: Spain (ended).
Therapeutic area(s): Analytical, Diagnostic and Therapeutic Techniques and Equipment [E] - Equipment and Supplies [E07]; Diseases [C] - Respiratory Tract Diseases [C08]
Gender: Female, Male. Age: 18-64 years, 65+ years. Enrolment: 60.
Status: Ended. Start date (EU): 2024-11-27. End date (EU): 2024-11-27. Decision date: 2024-11-27. Results received: No. Last updated: 2024-11-27.

Condition(s): ILD
Product: CONOXIA, gas medicinal comprimido, Conoxia 100% medicinal gas, cryogenic

Primary endpoint: The primary endpoint will be the average SpO₂ achieved throughout the entire training period, comparing both groups.
Endpoint(s): Dyspnea during daily life activities (mMRC scale, dyspnea domain of the CRQ), Dyspnea during exertion before and after the 6-minute walk test (6MWT) (Borg scale), Exercise capacity measured by the 6MWT without oxygen support, Health-Related Quality of Life (HRQoL) assessed using the KBILD and SF36 questionnaires, Full pulmonary function test (spirometry, lung volumes, diffusion, and blood gases), Adverse effects of the program, Adverse events, Program adherence

Source: https://euclinicaltrials.eu/ctis-public/view/2024-519541-30-00